EU clinical trial 2024-510770-25-00: A Phase 3, Randomized, Double-blind, Placebo-controlled Study to Evaluate the Safety and Efficacy of Adjunctive KarXT in Subjects with Inadequately Controlled Symptoms of Schizophrenia
Protocol code: KAR-012
Sponsor: Karuna Therapeutics Inc. (Pharmaceutical company). Phase: Therapeutic confirmatory (Phase III). Countries: Bulgaria (ended).
Therapeutic area(s): Psychiatry and Psychology [F] - Mental Disorders [F03]
Gender: Female, Male. Age: 18-64 years, 65+ years. Enrolment: 65.
Status: Ended. Start date (EU): 2023-03-22. End date (EU): 2025-02-24. End date: 2025-03-19. Decision date: 2024-06-14. Results received: Yes. Last updated: 2025-03-19.

Condition(s): Schizophrenia
Product: KarXT Matching Placebo, KarXT, KarXT, KarXT, KarXT

Primary endpoint: Change from Baseline in PANSS total score at Week 6
Endpoint(s): Change from Baseline in PSP at Week 6, Change from Baseline in CGI-S at Week 6, Change from Baseline in PANSS M-Pos Symptom Factor score at Week 6, Change from Baseline in PANSS M-Neg symptom factor score at Week 6, Categorical response defined as the proportion of subjects achieving a ≥ 30% improvement in PANSS total score at Week 6, POM at Week 6

Source: https://euclinicaltrials.eu/ctis-public/view/2024-510770-25-00